EU clinical trial 2024-513888-99-00: A Randomized, Double-Blind, Placebo-Controlled Multiple-Center, Efficacy and Safety Study of ZYN002 Administered as a Transdermal Gel to Children, Adolescents, and Young Adults with Fragile X Syndrome - RECONNECT
Protocol code: ZYN2-CL-033
Sponsor: Harmony Biosciences Management Inc. (Pharmaceutical company). Phase: Therapeutic confirmatory (Phase III). Countries: Ireland (ended).
Therapeutic area(s): Diseases [C] - Congenital, Hereditary, and Neonatal Diseases and Abnormalities [C16]
Gender: Female, Male. Age: 0-17 years, 18-64 years. Enrolment: 7.
Status: Ended. Start date (EU): 2023-06-08. End date (EU): 2025-08-29. End date: 2025-08-30. Decision date: 2024-11-11. Results received: Yes. Last updated: 2025-07-01.

Condition(s): Fragile X syndrome (FXS)
Product: ZYN002 Transdermal Gel Cannabidiol (CBD), ZYN002 Placebo Transdermal Gel

Primary endpoint: Change from Baseline to Week 18 in the ABC-CFXS Social Avoidance subscale score in patients with complete methylation of the FMR1 gene.
Endpoint(s): Change from Baseline to Week 18 in ABC-CFXS Irritability subscale score in patients with complete methylation of the FMR1 gene., Percent of patients with any improvement on the CaGI-C at Week 18 for Social Interactions among patients with complete methylation of the FMR1 gene., Percent of patients rated as improved on the CGI-I scale (minimally, much, very much improved) at Week 18 among patients with complete methylation of the FMR1 gene., Change from Baseline to Week 18 in the ABC-CFXS Social Avoidance subscale score among all randomized patients (complete and partial methylation of the FMR1 gene)., Percent of patients with a clinically meaningful within-subject improvement from Baseline in ABC-CFXS Social Avoidance subscale score at Week 18 among patients., Percent of patients with a clinically meaningful within-subject improvement from Baseline in ABC-CFXS Irritability subscale score at Week 18 among patients., Change from Baseline in ABC-CFXS Social Avoidance and Irritability subscale scores at Weeks 10 and 14 in patients., Change from Baseline in ABC-CFXS Socially Unresponsive/Lethargic, Stereotypy, Inappropriate Speech, and Hyperactivity subscale scores at Weeks 10, 14, and 18 in patients., Percent of patients with any improvement on the CaGI-C at Week 18 for Social Avoidance and Isolation, Irritable and Disruptive Behaviors, and Overall Behavior among patients., Percent of patients with any improvement on the CaGI-C at Week 18 for Social Interactions among all randomized patients., Percent of patients rated as improved on the CGI-I scale (minimally, much, very much improved) at Week 18 among all randomized patients., Incidence of TEAEs and SAEs by relationship to treatment and severity; incidence of SAEs/AEs leading to treatment discontinuation., Changes in vital signs, clinical laboratory tests, and ECG.

Source: https://euclinicaltrials.eu/ctis-public/view/2024-513888-99-00